EU clinical trial 2024-511016-25-00: Controlled Interruption of Nucleos(t)ide Analogue Treatment in Chronic Hepatitis B Infections
Sponsor: Antwerp University Hospital (Hospital/Clinic/Other health care facility). Phase: Therapeutic exploratory (Phase II). Countries: Belgium (ongoing, recruitment ended).
Therapeutic area(s): Diseases [C] - Virus Diseases [C02]
Gender: Female, Male. Age: 18-64 years, 65+ years. Enrolment: 140.
Status: Ongoing, recruitment ended. Start date (EU): 2025-01-15. Decision date: 2025-01-15. Results received: No. Last updated: 2025-01-15.

Condition(s): Chronic hepatitis B infection
Product: Vemlidy 25 mg film-coated tablets, Tenofovir disoproxil Viatris 245 mg film-coated tablets, Tenofovir disoproxil Viatris 245 mg film-coated tablets, Baraclude 1 mg film-coated tablets, Entecavir Krka 1 mg filmomhulde tabletten, Viread 245 mg film-coated tablets, Baraclude 0.5 mg film-coated tablets, Tenofovir disoproxil Viatris 245 mg film-coated tablets, Viread 245 mg film-coated tablets, Entecavir Krka 0,5 mg filmomhulde tabletten

Primary endpoint: The primary endpoint of this study is the occurrence of viral control defined as HBV DNA ≤2000 IU/mL and ALT ≤2xULN 72 weeks after treatment cessation.
Endpoint(s): The secondary endpoint of this study is HBsAg loss at week 72 after treatment cessation.

Source: https://euclinicaltrials.eu/ctis-public/view/2024-511016-25-00